EU clinical trial 2024-514900-16-00: Short course antibiotic treatment of Gram-negative bacteremia: A multicenter, randomized, non-blinded, non-inferiority interventional study
Protocol code: 2019-003282-17
Sponsor: Region Hovedstaden (Hospital/Clinic/Other health care facility). Phase: Therapeutic use (Phase IV). Countries: Denmark (ongoing, recruiting).
Therapeutic area(s): Diseases [C] - Bacterial Infections and Mycoses [C01]
Gender: Female, Male. Age: 18-64 years, 65+ years. Enrolment: 380.
Status: Ongoing, recruiting. Start date (EU): 2024-07-25. Decision date: 2024-07-25. Results received: No. Last updated: 2026-06-12.

Condition(s): Gram-negative Bacteremia
Product: Selexid, Piperacillin/Tazobactam "Stragen", pulver til infusionsvæske, opløsning, Sulfametizol ”Alternova”, tabletter, Nitrofurantoin "EQL Pharma", tabletter, Nebcina, injektionsvæske, opløsning, Ciprofloxacin "HEXAL", filmovertrukne tabletter, Sulfametoxazol med trimetoprim SAD, tabletter, Ciprofloxacin "HEXAL", filmovertrukne tabletter, Ciprofloxacin "HEXAL", filmovertrukne tabletter, Meropenem ”Stada”, pulver til injektions- og infusionsvæske, opløsning, Bioclavid, filmovertrukne tabletter, Ciprofloxacin Fresenius Kabi, Ampicillin "PCD", pulver til injektionsvæske, opløsning, Ertapenem Fresenius Kabi, Ampicillin "PCD", pulver til injektionsvæske, opløsning, Meropenem ”Stada”, pulver til injektions- og infusionsvæske, opløsning, Hexamycin, injektionsvæske, opløsning, Selexid, Ceftazidim "Fresenius Kabi", pulver til injektionsvæske, opløsning, Selexid, Piperacillin/Tazobactam "Stragen", pulver til infusionsvæske, opløsning, Trimopan, filmovertrukne tabletter

Primary endpoint: 90-day survival without clinical or microbiological failure to treatment
Endpoint(s): Mortality (timeframe 14, 30 and 90 days), Total duration of antibiotic treatment (timeframe 90 days), Type of antibiotic treatment (timeframe 90 days), Duration of antibiotic treatment (timeframe 90 days), Total length of hospital stay (timeframe 90 days), Hospital re-admission, Antibiotic adverse events (timeframe 30 and 90 days), Use of antimicrobials after discharge (timeframe 90 days), Severe adverse events (timeframe 90 days), Acute kidney injury (timeframe 90 days), Clostridioides difficile infection - Number of participants with Clostridioides difficile infection (timeframe 90 days), Multidrug-resistance organism: Multidrug-resistance organism defined as identification of resistant bacteria in a clinical specimen obtained only from a clinical infection. (timeframe 90 days)

Source: https://euclinicaltrials.eu/ctis-public/view/2024-514900-16-00